EU clinical trial 2025-522904-26-00: Clinical Study to Evaluate the Effects of Cevostamab in Patients with Lupus with or without Active Lupus Nephritis
Protocol code: GA46280
Sponsor: Genentech Inc. (Pharmaceutical company). Phase: Human Pharmacology (Phase I)- Other. Countries: Italy (authorised, recruitment pending), Spain (authorised, recruiting), France (authorised, recruitment pending), Germany (authorised, recruitment pending).
Therapeutic area(s): Diseases [C] - Immune System Diseases [C20]
Gender: Female, Male. Age: 18-64 years, 65+ years. Enrolment: 17.
Start date (EU): 2026-07-17. Decision date: 2026-04-22. Results received: No. Last updated: 2026-07-31.
Decision dates by country: DE: 2026-04-27, IT: 2026-04-22, ES: 2026-04-27, FR: 2026-04-22

Condition(s): Systemic Lupus Erythematosus (SLE) With or Without Active Lupus Nephritis (LN)

Source: https://euclinicaltrials.eu/ctis-public/view/2025-522904-26-00